EU clinical trial 2024-516402-32-00: Eculizumab in hypertensive emergency-associated hemolytic uremic syndrome: a randomized multicenter controlled trial (HYPERSHU)
Protocol code: APHP211039
Sponsor: Assistance Publique Hopitaux De Paris (Hospital/Clinic/Other health care facility). Phase: Therapeutic confirmatory (Phase III). Countries: France (ongoing, recruiting).
Therapeutic area(s): Diseases [C] - Cardiovascular Diseases [C14]
Gender: Female, Male. Age: 18-64 years, 65+ years. Enrolment: 66.
Status: Ongoing, recruiting. Start date (EU): 2024-02-13. Decision date: 2024-11-12. Results received: No. Last updated: 2026-03-09.

Condition(s): Adult patients with aHUS associated with HE and severe kidney involvement (needing dialysis or serum creatinine ≥ 354μM)
Product: ECULIZUMAB, ECULIZUMAB

Primary endpoint: Response to therapy, defined by the absence of any of the following events: i) at 6-month follow-up: persistent renal replacement therapy, eGFR<15ml/mn/1,73m2, or patient death; ii) at W2 : persistent hemolysis despite well conducted antihypertensive therapy. Any Eculizumab rescue in the control group will be considered as a failure.
Endpoint(s): Prognosis role of repeat complement biomarkers (W1, W4, W13), Frequency of Complement genetic rare variants, Renal replacement therapy rates at months 3 and 12 follow-up, Frequency of severe infections (defined by the need for hospitalization), Time to resolution of haemolysis, Time to resolution of renal replacement therapy, Frequency and prognostic role of kidney lesions (glomerular and arteriolar microthromboses), glomerulosclerosis and kidney fibrosis if kidney biopsy is performed, Costs relating to renal replacement therapy (or lack of), Eculizumab and other antihypertensive treatments, hospitalizations

Source: https://euclinicaltrials.eu/ctis-public/view/2024-516402-32-00